EU clinical trial 2022-502151-54-00: Efficacy and Tolerability of AP707 in Patients with Chronic Back Pain
Protocol code: DISCOVER_(MBP)
Sponsor: Cannaxan GmbH, Apurano Pharmaceuticals GmbH (Pharmaceutical company). Phase: Therapeutic confirmatory (Phase III). Countries: Germany (ended), Austria (ended).
Therapeutic area(s): Diseases [C] - Pathological Conditions, Signs and Symptoms [C23]
Gender: Female, Male. Age: 18-64 years, 65+ years. Enrolment: 558.
Status: Ended. Start date (EU): 2023-11-02. End date (EU): 2026-03-10. Decision date: 2023-04-05. Results received: No. Last updated: 2024-11-22.
Decision dates by country: AT: 2023-04-11, DE: 2023-04-05

Condition(s): Chronic back pain
Product: NAPROXEN, PARACETAMOL, PHENAZONE, DICLOFENAC, KETOPROFEN, DEXIBUPROFEN, ACECLOFENAC, ACEMETACIN, TIAPROFENIC ACID, DEXKETOPROFEN, Pump spray for sublingual application in 20 mL pump spray bottles. The placebo contains all excipients of AP707 without the addition of cannabis sativa (active ingredient). The appearance of the preparation is a brown-beige with a characteristic sweet and slightly fruity odor., ACETYLSALICYLIC ACID, IMIPRAMINE, CELECOXIB, AMITRIPTYLINE, METAMIZOLE SODIUM

Primary endpoint: 1) Change in pain level on the Numeric Rating Scale (NRS, 0-10) between baseline and at treatment week 14 (end of first treatment phase) in comparison of study arm 1 (verum) and study arm 2 (placebo)
Endpoint(s): 2) Change in pain level on the Numeric Rating Scale (NRS, 0-10) between baseline and at treatment week 26 (end of second treatment phase) in comparison of study arm 1 (verum) and study arm 2 (placebo), 3) Change in pain level on the Numeric Rating Scale (NRS, 0-10) between baseline and at treatment week 52 (end of third treatment phase) in comparison of study arm 1 (verum) and study arm 2 (placebo), 4) Change in the pain score of the Neuropathic Pain Symptom Inventory (NPSI) questionnaire between baseline established in the last week before start of randomized treatment and at treatment week 14 (end of first treatment phase), at treatment week 26 (end of second treatment phase), and at treatment week 52 (end of third treatment phase) in comparison of study arm 1 (verum) and study arm 2 (placebo), 5) Change in pain level on the Numeric Rating Scale (0-10) between baseline and in treatment week 5, 11, 18, 22, 30, 34, 43, 47 in comparison of study arm 1 (verum) and study arm 2 (placebo), 6) Responder analysis for endpoints 1), 2), 3) and 4) for treatment week 14, 26 and 52: a) Proportion of patients who experienced > 30 % improvement in pain score (Numeric Rating Scale); b) Proportion of patients who experienced > 40 % improvement in pain score (Numeric Rating Scale); c) Proportion of patients who experienced > 50 % improvement in pain score (Numeric Rating Scale), 7) Change in sCPT (percentage of change in dosage and percentage of change in combination of analgesic measures) in both study arms from start to week 14, 8) Change in pain-related impairment according to von Korff et al. from baseline established in the last week before start of randomized treatment to week 14, 26, and 52, 9) Change in psychological distress using Depression Anxiety Stress Scales Short Form (DASS-21) questionnaire from baseline established in the last week before start of randomized treatment to week 14, 26, and 52, 10) Change of Patient Global Impression of Change (PGIC) from start to week 14, 26, and 52, 11) Change in quality of life using the Veterans RAND (VR-12) questionnaire from baseline established in the last week before start of randomized treatment to week 14, 26, and 52, 12) Change in sleep quality using the Regensburg Insomnia Scale (RIS) from baseline established in the last week before start of randomized treatment to week 14, 26, and 52, 13) Change in pain score of the Brief Pain Inventory - Short Form (BPI-SF) questionnaire from baseline established in the last week before start of randomized treatment to week 14, 26, and 52, 14) Area under NRS-curve until treatment week 5, 11, 14, 18, 22, 26, 30, 34, 39, 43, 47, 52, 15) Change in VR-12 components (physical component summary PCS, mental component summary MCS) from baseline established in the last week before start of randomized treatment to week 14, 26, and 52, 16) Number of patients with rescue medication over the course of the clinical trial and within periods: until treatment week ≤5, ≤11, ≤14, ≤18, ≤22, ≤26, ≤30, ≤34, ≤43, ≤47, ≤52, 17) Number and severity of adverse events (AE)

Source: https://euclinicaltrials.eu/ctis-public/view/2022-502151-54-00